EU clinical trial 2024-518758-18-02: Phase I, single and multiple ascending dose, randomized, double-blind, placebo-controlled, parallel-group clinical trial to evaluate the safety, tolerability and pharmacokinetics of topical ocular administration of DS101 in healthy subjects.
Protocol code: DS101-CT-01
Sponsor: Fundacio Hospital Universitari Vall D’Hebron Institut De Recerca (Laboratory/Research/Testing facility). Phase: Human Pharmacology (Phase I)- First administration to humans. Countries: Spain (ongoing, recruiting).
Therapeutic area(s): Diseases [C] - Eye Diseases [C11]
Gender: Female, Male. Age: 18-64 years, 65+ years. Enrolment: 12.
Status: Ongoing, recruiting. Start date (EU): 2026-03-03. Decision date: 2025-08-01. Results received: No. Last updated: 2026-05-29.

Condition(s): Diabetic retinopathy.

Source: https://euclinicaltrials.eu/ctis-public/view/2024-518758-18-02